EU clinical trial 2024-510812-64-00: A Prospective, Randomized, Controlled, Open-label, Multicenter Trial to Evaluate Efficacy, Safety and Patient-reported Outcomes of Peptide Receptor Radionuclide Therapy (PRRT) with Lutetium (177Lu) Edotreotide compared to Best Standard of Care in Patients with Well-differentiated Aggressive Grade 2 and Grade 3, Somatostatin Receptor‑positive (SSTR+), Neuroendocrine Tumors of GastroEnteric or Pancreatic Origin
Protocol code: DP-1111-02CT
Sponsor: ITM Solucin GmbH (Pharmaceutical company). Phase: Therapeutic confirmatory (Phase III). Countries: Netherlands (ongoing, recruitment ended), Spain (ongoing, recruitment ended), Italy (ongoing, recruitment ended), France (ongoing, recruitment ended), Germany (ongoing, recruitment ended).
Therapeutic area(s): Diseases [C] - Neoplasms [C04]
Gender: Female, Male. Age: 18-64 years, 65+ years. Enrolment: 153.
Status: Ongoing, recruitment ended. Start date (EU): 2021-09-30. Decision date: 2024-07-15. Results received: No. Last updated: 2026-07-20.
Decision dates by country: FR: 2024-07-23, ES: 2024-07-16, NL: 2024-07-15, IT: 2024-08-05, DE: 2024-07-23

Condition(s): Well-differentiated Aggressive Grade 2 and Grade 3, Somatostatin receptor-positive (SSTR+), Neuroendocrine Tumors of GastroEnteric or Pancreatic Origin (GEP-NET)
Product: Arginine-Lysine solution for infusion, CAPECITABINE, FLUOROURACIL, OXALIPLATIN, SODIUM FOLINATE, TEMOZOLOMIDE, 177Lu-Edotreotide, CALCIUM FOLINATE, EVEROLIMUS

Primary endpoint: Progression-free survival (PFS), defined as the time from randomization until adequately documented Response Evaluation Criteria in Solid Tumors (RECIST) v1.1 disease progression (based on blinded, central assessment) or death.
Endpoint(s): 1. Further demonstration of efficacy:, 1.1 Overall survival (OS), defined as the time from randomization until death., 1.2 PFS (local), defined as the time from randomization until adequately documented RECIST v1.1 disease progression (based on local assessment) or death., For all the endpoints below based on RECIST v1.1, main analyses will be based on blinded, central assessment. Local assessments will be presented as sensitivity analyses., 1.3 Disease control rate (DCR), defined as the proportion of randomized patients with complete response (CR), partial response (PR), or stable disease (SD) (RECIST v1.1)., 1.4 Duration of disease control (DDC), defined as the time from experiencing CR, PR or SD until the next subsequent progressive disease (PD) (RECIST v1.1) or death., 1.5 Objective response rate (ORR), defined as the proportion of randomized patients with CR or PR (RECIST v1.1)., 1.6 Duration of response (DoR), defined as the time from experiencing first CR or PR until PD (RECIST v1.1) or death., 2. Two HRQL (European Organisation for Research and Treatment of Cancer [EORTC]) quality of life questionnaires ([QLQ]-C30 and –GI.NET21):, 2.1 Maximum HRQL improvement in total scores relative to baseline., 2.2 Duration of maximum HRQL improvement, defined as the time from maximum improvement until subsequent deterioration., 2.3 Time to HRQL deterioration, defined as the time from randomization until first HRQL deterioration., 3. Safety and tolerability based on adverse events (AEs), laboratory data and vital signs.

Source: https://euclinicaltrials.eu/ctis-public/view/2024-510812-64-00